EU clinical trial 2024-516242-19-00: OBILUP. Induction therapy for lupus nephritis with no added oral corticosteroids : An open label randomised multicentre controlled trial comparing oral corticosteroids plus mycophenolate mofetil (MMF) versus Obinutuzumab and MMF.
Protocol code: APHP200038
Sponsor: Assistance Publique Hopitaux De Paris (Hospital/Clinic/Other health care facility). Phase: Therapeutic confirmatory (Phase III). Countries: France (ongoing, recruiting).
Therapeutic area(s): Diseases [C] - Immune System Diseases [C20]
Gender: Female, Male. Age: 0-17 years, 18-64 years, 65+ years. Enrolment: 196.
Status: Ongoing, recruiting. Start date (EU): 2024-11-05. Decision date: 2024-11-05. Results received: No. Last updated: 2026-05-18.

Condition(s): lupus nephritis
Product: MYCOPHENOLATE MOFETIL, PREDNISOLONE, MYCOPHENOLATE MOFETIL, AZATHIOPRINE, Gazyvaro 1,000 mg concentrate for solution for infusion., AZATHIOPRINE

Primary endpoint: Complete renal response (CR) at week 52 is defined as: - Urine PCR (protein to creatinine ratio) < 0.5 g/g - AND: eGFR (estimated glomerular filtration rate using CKD-epi) ≥ 60 ml/min, or if < 60 ml/min at screening, no decline >20% compared to screening/randomisation (whichever worse) - AND: o In the obinutuzumab arm: with no corticosteroids or without receiving oral corticosteroids > 10 mg/day within the first 6 month, and then, without receiving oral corticosteroids > 7.5 mg/day between 6 an
Endpoint(s): Efficacy - Partial renal response (PR) will be defined as: o 50% improvement in spot uPCR o AND uPCR between 0.5 and 3 g/g o AND eGFR (estimated glomerular filtration rate using CKD-epi) ≥ 60 ml/min, or if < 60 ml/min at screening, no decline >20% compared to screening/randomisation (whichever worse) - Complete renal response (independently of the treatment): see primary outcome - Proteinuria measurement: see primary outcome [1] - Extrarenal flare will be defined according to the SELENA-SLEDAI, Safety - Toxicity of corticosteroids will be measured with the Glucocorticoid Toxicity Index (GTI) (see Appendix D) - The number of serious adverse events will be measured per patient according to the CTCAE (version 5.0) toxicity grading system for the following adverse events combined: death (all causes), grade 3 or higher infections, hospitalization resulting either from the disease or from a complication due to the study treatment. - The number of serious infectious episodes will be measured, Non-adherence to treatment will be assessed with hydroxychloroquine blood levels and with questionnaires., Efficiency: incremental cost effectiveness ratio in cost per QALY.

Source: https://euclinicaltrials.eu/ctis-public/view/2024-516242-19-00